EU clinical trial 2023-505532-35-00: CAPSI - Cancer related major depression treated with a single dose of psilocybin - a multicenter randomized placebo controlled double blind clinical trial
Sponsor: Region Stockholm – SLSO (Hospital/Clinic/Other health care facility). Phase: Therapeutic exploratory (Phase II). Countries: Sweden (temporarily halted).
Therapeutic area(s): Diseases [C] - Neoplasms [C04]; Psychiatry and Psychology [F] - Mental Disorders [F03]
Gender: Female, Male. Age: 18-64 years, 65+ years. Enrolment: 120.
Status: Temporarily halted. Start date (EU): 2024-05-15. Decision date: 2023-11-16. Results received: No. Last updated: 2026-07-03.

Condition(s): Major Depressive Disorder, Malignant tumours ICD 10 C00 to C97
Product: UCB-J, PEX010 (Psilocybin Capsules 25 mg), PEX010 Psilocybin Capsules (1.0 mg psilocybin)

Primary endpoint: The primary endpoint for the acute-phase (Day 0 to Day 42) is the endpoint score on the observer-rated MADRS total score. This will be assessed using ANCOVA. The primary endpoint for the follow-up phase (Day 43 to Day 180) is days to initiation of antidepressant treatment (antidepressants or psychotherapy) or hospitalization for depression from Day 43 to the date when either of the events has occurred.
Endpoint(s): MADRS at day 8 (ANCOVA x1) MADRS-S at all evaluations between Day 0 and Day 42 (MMRM x1) SDS, GAD-7 and HADS at Day 42 (ANCOVA x3) CGI, EQ-5D-5L at Day 8 and Day 42 (ANCOVA x6) AQOL-6D at Day 42 (ANCOVA x1). MADRS at Day 90 and Day 180 (ANCOVA x2) MADRS-S at all evaluations between Day 43 and Day 180 (MMRM x1) SDS, GAD-7, HADS at Day 180 (ANCOVA x3) CGI, EQ-5D-5L at Day 90 and Day 180 (ANCOVA x6) AQOL-6D at Day 90 and Day 180 (ANCOVA x2)

Source: https://euclinicaltrials.eu/ctis-public/view/2023-505532-35-00